EU clinical trial 2024-516228-33-00: A multicenter, register-based, randomized, controlled trial comparing dapagliflozin with metformin treatment in early stage type 2 diabetes patients by assessing mortality and macro- and microvascular complications
Protocol code: SMART-2019
Sponsor: Uppsala University (Educational Institution). Phase: Therapeutic use (Phase IV). Countries: Sweden (ongoing, recruiting).
Therapeutic area(s): Diseases [C] - Nutritional and Metabolic Diseases [C18]
Gender: Female, Male. Age: 18-64 years, 65+ years. Enrolment: 2200.
Status: Ongoing, recruiting. Start date (EU): 2024-08-30. Decision date: 2024-08-30. Results received: No. Last updated: 2024-08-30.

Condition(s): Type 2 Diabetes
Product: METFORMIN, DAPAGLIFLOZIN

Primary endpoint: Time to first of: 1. All-cause death 2. Major adverse cardiovascular events (MACE; myocardial infarction, stroke, heart failure) 3. Microvascular events (occurrence or progression of retinopathy, nephropathy, or diabetic foot lesions)
Endpoint(s): Modified composite endpoint with weighted components 1-3 of primary endpoint based on their individual degrees of severity (falling in that order). Ordinal analysis at 2 years of follow-up., Time to first event among: individual components of the primary endpoint or initiation of insulin treatment., Time to first of: non-fatal myocardial infarction, stroke, heart failure, unstable angina or cardiovascular death, Time to first of: heart failure or cardiovascular death Time to event of death, Time to first microvascular event; occurrence or progression of retinopathy, nephropathy, diabetic foot lesions, Time to initiation of insulin treatment, Time to any treatment failure, defined as add-on or switch to another GLD, Change in: 1) HbA1c 2) total cholesterol 3) LDL- cholesterol 4) HDL-cholesterol 5) Triglycerides 6) Urinary albumin/creatinine ratio 7) BMI 8) Systolic blood pressure 9) Diastolic blood pressure, Diagnosis-based (IDG) costs for all health care during study period plus medication cost, Results from RAND-36 and DTSQ questionnaires, 0-2 years after randomization., Occurrence of SAEs (all non-elective hospitalisations or other SAEs)., Occurrence of diabetes- and treatment-specific SAEs (hospitalisations for diabetes, severe hypoglycaemia, ketoacidosis, lactate acidosis, diabetic coma, amputations, fractures).

Source: https://euclinicaltrials.eu/ctis-public/view/2024-516228-33-00